EU clinical trial 2024-511403-41-00: A 3-Arm, Randomized, Blinded, Active-Controlled, Phase II Study of RO7121661, a PD1-TIM3 Bispecific Antibody and RO7247669, a PD1-LAG3 Bispecific Antibody, Compared With Nivolumab in Participants With Advanced or Metastatic Squamous Cell Carcinoma of the Esophagus
Protocol code: BP42772
Sponsor: F. Hoffmann-La Roche AG (Pharmaceutical company). Phase: Therapeutic exploratory (Phase II). Countries: Italy (ended), Hungary (ended), Denmark (ended), France (ended), Spain (ended), Poland (ended).
Therapeutic area(s): Diseases [C] - Neoplasms [C04]
Gender: Female, Male. Age: 18-64 years, 65+ years. Enrolment: 79.
Status: Ended. Start date (EU): 2021-04-14. End date (EU): 2024-12-18. End date: 2025-01-31. Decision date: 2024-10-31. Results received: Yes. Last updated: 2024-11-12.
Decision dates by country: HU: 2024-11-05, PL: 2024-11-05, DK: 2024-10-31, FR: 2024-10-31, IT: 2024-11-12, ES: 2024-11-04

Condition(s): Advanced or metastatic squamous cell carcinoma of the esophagus

Primary endpoint: 1. Overall survival
Endpoint(s): 1. Frequency, and severity of adverse events (AEs) graded according to the National Cancer Institute Common Terminology Criteria for Adverse Events version 5.0 (NCI-CTCAE v5.0), 2. ORR, defined as the proportion of participants with an objective response (i.e., complete response [CR] or partial response [PR]), according to RECIST v1.1, 3. DCR defined as ORR plus stable disease rate (SDR), 4. DoR for participants with ORR, defined as the time from the first occurrence of a documented objective response to disease progression according to RECIST v1.1 or death from any cause, whichever occurs first, 5. PFS defined as the time from randomization to the first occurrence of progression as determined according to RECIST v1.1 or death during the treatment period or within 60 days of the last tumor assessment after treatment discontinuation from any cause, whichever occurs first, 6. Percentage of participants reporting clinically meaningful improvement in global health status/quality of life, emotional functioning, social functioning and dysphagia as measured by the European Organisation for Research and Treatment of Cancer (EORTC) Quality of life questionnaire (QLQ)-C30, defined as an improvement of at least 10 points, 7. Percentage of participants reporting clinically meaningful improvement in global health status/quality of life, emotional functioning, social functioning and dysphagia as measured by the EORTC-QLQ-IL97, defined as an improvement of at least 10 points, 8. Percentage of participants reporting clinically meaningful improvement in global health status/quality of life, emotional functioning, social functioning and dysphagia as measured by the EORTC-QLQ-OES-18, defined as an improvement of at least 10 points, 9. Serum concentrations of RO7121661, 10. Serum concentrations of RO7247669, 11. Serum concentrations of nivolumab, 12. Incidence and titer of anti-drug antibodies (ADAs) against RO7121661 during the study relative to the prevalence of ADAs at baseline, 13. Incidence and titer of ADAs against RO7247669 during the study relative to the prevalence of ADAs at baseline, 14. Incidence and titer of ADAs against nivolumab during the study relative to the prevalence of ADAs at baseline, 15. Changes from baseline in the phenotype and activation status (CD4/CD8 HLA-DR+Ki67+) of T cell subsets in the peripheral blood, 16. Changes from baseline such as CD8 T cell infiltration, proliferation (CD8+Ki67+) in the tumor microenvironment, 17. Baseline PDL1, CD8+PD1+, CD8+TIM3+, and CD8+LAG3+ expression in the tumor microenvironment

Source: https://euclinicaltrials.eu/ctis-public/view/2024-511403-41-00